EU clinical trial 2023-506820-10-00: An Open-Label, Multicenter, Phase I/II Trial Evaluating the Safety, Efficacy, and Pharmacokinetics of Escalating Doses of Mosunetuzumab (BTCT4465A) as a Single Agent and Combined with Atezolizumab in Patients with Relapsed or Refractory B-Cell Non-Hodgkin’s Lymphoma and Chronic Lymphocytic Leukemia
Protocol code: GO29781
Sponsor: Genentech Inc. (Pharmaceutical company). Phase: Phase I and Phase II (Integrated)- Other. Countries: Spain (ended), Germany (ended).
Therapeutic area(s): Diseases [C] - Neoplasms [C04]
Gender: Female, Male. Age: 18-64 years, 65+ years. Enrolment: 65.
Status: Ended. Start date (EU): 2024-06-11. End date (EU): 2025-09-01. End date: 2025-09-02. Decision date: 2024-06-10. Results received: Yes. Last updated: 2025-09-22.
Decision dates by country: ES: 2024-06-10, DE: 2024-06-25

Condition(s): B-Cell Malignancies
Product: Mosunetuzumab, Mosunetuzumab, Mosunetuzumab, Tecentriq 1 200 mg concentrate for solution for infusion, RoActemra 20 mg/mL concentrate for solution for infusion, Mosunetuzumab, Mosunetuzumab, Mosunetuzumab

Primary endpoint: 1. Safety: Incidence and nature of dose-limiting toxicity (DLTs) when mosunetuzumab is given as a single agent IV or SC, 2. Safety: Incidence and nature of DLTs when mosunetuzumab is given in combination with atezolizumab, 3. Efficacy: Independent Review Facility (IRF)-assessed complete response (CR) rate, defined as the proportion of patients whose best overall response is a CR based upon IRF assessment using standard criteria for NHL, 4. PK: Serum concentration of mosunetuzumab at specified timepoints, 5. PK: The following PK parameters (if data allows): •AUC, Cmax, Cmin, CL, and Vss, 6. PK: Other parameters such as accumulation ratio, half-life, and dose proportionality may also be calculated, 7. PKNI: Observed Cycle 3 (i.e., pre-dose Cycle 4) serum Ctrough concentration (CtroughCYC3_OBS), 8. PKNI: Cumulative AUC over 0−84 days (AUC0-84)
Endpoint(s): 1. Safety: Incidence, nature, and severity of adverse events (AEs), 2. Safety: Incidence of anti-drug antibodies (ADAs) against mosunetuzumab and atezolizumab, and their relationship to clinical outcomes, 3. Safety: Changes in vital signs and clinical laboratory values, 4. Efficacy: Investigator-assessed CR rate, defined as the proportion of patients whose best overall response is a CR based upon investigator assessment using standard criteria for NHL, 5. Efficacy: IRF and investigator assessed objective response rate (ORR), defined as the proportion of patients whose best overall response is a PR or CR using standard criteria for NHL, 6. Efficacy: IRF and investigator assessed duration of complete response, defined as the time from the initial occurrence of a documented CR until documented disease progression or death due to any cause, whichever occurs first, using standard criteria for NHL, 7. Efficacy: IRF and investigator assessed duration of response, defined as the time from the initial occurrence of a documented PR or CR until documented disease progression or death due to any cause, whichever occurs first, using standard criteria for NHL, 8. Efficacy: IRF and investigator assessed progression-free survival (PFS), defined as the time from the first study treatment to the first occurrence of disease progression or death from any cause, whichever occurs first, using standard criteria for NHL, 9. Efficacy: Overall survival (OS), defined as the time from the first study treatment to the date of death from any cause, 10. PRO: The HRQoL and health status measures that will be used in NHL expansion cohorts to evaluate PROs are as follows: •Summary statistics and change from baseline in HRQoL based on EORTC QLQ C30 •Summary statistics and change from baseline in disease-related symptoms based on the FACT-Lym subscale •Descriptive results of the EQ-5D-5L data during patients’ participation in the study, 11. Pharmacokinetic Non-Inferiority (PKNI): Observed Cycle 2 (i.e., pre-dose Cycle 3) serum Ctrough concentration (CtroughCYC2_OBS), 12. PKNI: Modeled Cycle 2 (i.e., pre-dose Cycle 3) serum Ctrough concentration (CtroughCYC2), derived using EBEs or virtual trial simulations, data permitting, 13. PKNI: Modeled Cycle 3 (pre-dose Cycle 4) serum Ctrough concentration (CtroughCYC3), derived using EBEs or virtual trial simulations, data permitting, 14. PKNI: Modeled AUC at steady state (AUCSS), as approximated by AUC of Cycle 4 using EBEs or virtual trial simulations, data permitting

Source: https://euclinicaltrials.eu/ctis-public/view/2023-506820-10-00